EU clinical trial 2025-522278-35-00: A Phase 2a randomized, observer-blind, study to evaluate the immunogenicity and safety of mRNA-based multivalent seasonal influenza vaccine candidates in adults 18 years of age and older.
Protocol code: 300356
Sponsor: GlaxoSmithKline Biologicals (Pharmaceutical company). Phase: Therapeutic exploratory (Phase II). Countries: Belgium (ended).
Therapeutic area(s): Diseases [C] - Virus Diseases [C02]
Gender: Female, Male. Age: 18-64 years, 65+ years. Enrolment: 150.
Status: Ended. End date (EU): 2025-09-10. End date: 2026-06-23. Decision date: 2025-09-09. Results received: No. Last updated: 2025-09-09.

Condition(s): Influenza, Human
Product: Alpharix suspensie voor injectie in een voorgevulde spuit Trivalent griepvaccin (gefragmenteerd virion, geïnactiveerd)

Primary endpoint: Primary end points 1 • Antigen 1 antibody titer at Day 29, • Fold increase in antigen 1 antibody titer from Day 1 to Day 29, • Antigen 1 antibody seroconversion from Day 1 to Day 29, • Antigen 1 antibody seroprotection at Day 1 and Day 29, Primary end points 2 • Occurrence of solicited administration site or systemic events with onset within 7 days of study intervention, • Occurrence of unsolicited AEs within 28 days of study intervention, • Occurrence of SAEs within 6 months of study intervention, • Occurrence of AESIs within 6 months of study intervention, • Occurrence of MAAEs within 6 months of study intervention, • Occurrence of any laboratory abnormalities pre-dose (Day 1), post-Dose (Day 3, Day 8, Day 29)
Endpoint(s): Secondary end points 1 - • Antigen 2 antibody titer at Day 29, • Fold increase in antigen 2 antibody titer from Day 1 to Day 29, • Antigen 2 antibody seroconversion from Day 1 to Day 29

Source: https://euclinicaltrials.eu/ctis-public/view/2025-522278-35-00